EU clinical trial 2022-502375-37-00: Determining the optimal strategy for stopping chronic proton pump inhibitor therapy in primary care patients: impact of on-demand use, adjustment of therapy or discontinuation.
Protocol code: PEPPER
Sponsor: UZ Leuven (Hospital/Clinic/Other health care facility). Phase: Therapeutic use (Phase IV). Countries: Belgium (ended).
Therapeutic area(s): Diseases [C] - Digestive System Diseases [C06]
Gender: Female, Male. Age: 18-64 years, 65+ years. Enrolment: 745.
Status: Ended. Start date (EU): 2023-04-16. End date (EU): 2026-03-25. Decision date: 2023-04-12. Results received: No. Last updated: 2026-02-09.

Condition(s): heartburn, Functional dyspepsia, reflux
Product: Maalox Antacid® Suikervrij Citroen 200 mg/400 mg kauwtabletten, Maalox Antacid® Citroen 230 mg/400 mg per 4,3 ml suspensie voor oraal gebruik, Maalox Antacid® 230mg/400 mg par 10 ml suspension buvable, Gaviscon Antizuur - Antireflux Unidose 500mg/213mg/325mg suspensie voor oraal gebruik in sachet., Maalox Antacid® 200 mg/400 mg kauwtabletten

Primary endpoint: the percentage of randomized patients achieving successful therapeutic outcome at the end of the follow up period in each treatment group. Successful therapeutic outcome is determined by the sum of the predefined 3 key points reported by the patient (the use of PPI, treatment satisfaction and willingness to continue with the treatment) during the follow up period.
Endpoint(s): For each study visit the result of each key indicator to achieve therapeutic success (separate PPI discontinuation, treatment satisfaction and willingness to continue) will be evaluated., For each study visit, the percentage of successful therapeutic outcome (sum of 3 key indicators, as defined for the primary outcome) will be evaluated., The percentage of weeks during the follow up period in which patients did not use PPI.

Source: https://euclinicaltrials.eu/ctis-public/view/2022-502375-37-00